EU clinical trial 2023-505247-39-00: Efficacy of intravenous dexamethasone in prolonging the duration of spinal anesthesia with chloroprocaine in knee arthroscopy.
Protocol code: 2023/01
Sponsor: Centre Medico Chirurgical Ambroise Pare Hartmann (Hospital/Clinic/Other health care facility). Phase: Therapeutic confirmatory (Phase III). Countries: France (authorised, recruitment pending).
Therapeutic area(s): Analytical, Diagnostic and Therapeutic Techniques and Equipment [E] - Anesthesia and Analgesia [E03]
Gender: Female, Male. Age: 18-64 years, 65+ years. Enrolment: 60.
Status: Authorised, recruitment pending. Decision date: 2026-04-08. Results received: No. Last updated: 2026-04-08.

Condition(s): Knee arthroscopy
Product: CHLORURE DE SODIUM PROAMP 0,9 %, solution injectable, DEXAMETHASONE VIATRIS 20 mg/5 ml, solution injectable en ampoule, CHLOROPROCAINE HYDROCHLORIDE

Primary endpoint: The primary endpoint is the time to regression of sensory block by two dermatomes, defined as the time (in minutes) from the spinal puncture to the regression of two dermatomes from the highest dermatome level of sensory block achieved after the puncture. Sensory block will be assessed every 5 minutes after spinal puncture using a pin-prick test (0-2: 0 = absent sensation; 1 = dull, decreased sensation; 2 = sharp, normal sensation).
Endpoint(s): Time (in minutes) from the spinal puncture to complete recovery of motor block, assessed by the Modified Bromage Scale (0–3: 0 = full flexion of hip, knee, and ankle; 1 = inability to raise extended leg; 2 = inability to flex knee; 3 = no movement of hip, knee, or ankle). Motor block will be assessed every 5 minutes after the spinal puncture until regression of the sensory block by two dermatomes, and then every 10 minutes until complete motor recovery (Bromage 0)., Time (in minutes) from the spinal puncture to regression of four dermatomes from the highest dermatome level of sensory block achieved after the puncture. Sensory block will be assessed using the pin-prick test every 5 minutes after the spinal puncture until regression by two dermatomes, and then every 10 minutes until regression by four dermatomes., Highest dermatome level of sensory block achieved after the spinal puncture assessed using the pin-prick test., Time (in minutes) from the spinal puncture to the highest blocked dermatome., Need (or not) for an additional anesthetic procedure (sedation or general anesthesia) will be recorded only in the case of intraoperative pain at the incision site, during surgical manipulation, or during tourniquet inflation. Such cases will be considered as failures of spinal anesthesia. If sedation is administered solely for anxiety in the operating room, preventing further sensory or motor assessment, the patient will be excluded from the per-protocol analysis., Time (in minutes) from the spinal puncture to regression of two dermatomes from the highest dermatome level of sensory block achieved after the puncture, assessed using the cold test. Cold sensation will be evaluated with a stainless-steel cylinder (2–4 °C). The cylinder will be applied gently for 1–2 seconds to each dermatome without pressure. The reference area (T4) will be used to define normal cold sensation., Any episode occurring from spinal puncture up to 24 hours after surgery, including: hypotension, bradycardia, nausea and vomiting, pruritus, urinary retention., Maximal pain score collected in the PACU using a Numeric Rating Scale (NRS-Pain) ranging from 0 to 10 (0= no pain; 10= extreme pain)., Total opioid consumption will be recorded and converted to oral morphine equivalents (OME, mg), including all opioids administered during the intraoperative period, in the PACU, during the ambulatory hospitalization until discharge, as well as those taken at home within 24 hours after surgery, as reported during the follow-up phone call at Day 1 (D1)., Pain intensity will be assessed using a Numeric Rating Scale (NRS, 0–10) at rest and during movement, and recorded during the intraoperative period (H0), in the PACU (H1 ± 30min), during the ambulatory hospitalization until discharge (H3 ± 1h and H6 ± 2h), and at home until D1 (H9 ± 2h, H12 ± 2h and H24 ± 3h)., Time (in minutes) between the skin incision and the last suture., Post puncture headache (Yes/No) evaluated at D1.

Source: https://euclinicaltrials.eu/ctis-public/view/2023-505247-39-00